EU clinical trial 2024-512136-30-00: An open label, Phase IV study to assess immunological changes in patients with glioblastoma multiforme treated with bevacizumab infusion
Sponsor: Orszagos Onkologiai Intezet (Hospital/Clinic/Other health care facility). Phase: Therapeutic use (Phase IV). Countries: Hungary (ongoing, recruiting).
Therapeutic area(s): Diseases [C] - Neoplasms [C04]; Diseases [C] - Nervous System Diseases [C10]
Gender: Female, Male. Age: 18-64 years, 65+ years. Enrolment: 175.
Status: Ongoing, recruiting. Start date (EU): 2024-06-28. Decision date: 2024-06-28. Results received: No. Last updated: 2024-06-28.

Condition(s): Glioblastoma multiforme
Product: BEVACIZUMAB, Avastin 25 mg/ml concentrate for solution for infusion., BEVACIZUMAB

Primary endpoint: 1. Immunological changes in patients during the course of the disease before and under bevacizumab treatment, which might predict the course of the disease. 2. Local relapse free survival 3. Progression free survival 4. Overall survival.
Endpoint(s): Investigation of plasma-derived extracellular vesicles (EV), their micro-RNA and protein content, and free DNA-RNA fragments. We do not perform genome sequencing.

Source: https://euclinicaltrials.eu/ctis-public/view/2024-512136-30-00